EU clinical trial 2025-520488-42-00: A Phase 2b Randomized, Double-blind, Placebo-controlled, Parallel-Group Study to Assess Efficacy and Safety of Verekitug (UPB-101) in Participants with Moderate-to-Severe Chronic Obstructive Pulmonary Disease (COPD)
Protocol code: UPB-CP-06
Sponsor: Upstream Bio Inc. (Pharmaceutical company). Phase: Therapeutic exploratory (Phase II). Countries: Romania (ongoing, recruitment ended), Lithuania (ongoing, recruitment ended), Hungary (ongoing, recruitment ended), Spain (ongoing, recruitment ended), Bulgaria (ongoing, recruitment ended), Ireland (ended), Germany (ongoing, recruitment ended), Latvia (ongoing, recruitment ended), Czechia (ongoing, recruitment ended), Poland (ongoing, recruitment ended), Slovakia (ongoing, recruitment ended).
Therapeutic area(s): Diseases [C] - Respiratory Tract Diseases [C08]
Gender: Female, Male. Age: 18-64 years, 65+ years. Enrolment: 287.
Start date (EU): 2025-09-17. Decision date: 2025-09-09. Results received: No. Last updated: 2026-03-25.
Decision dates by country: BG: 2025-09-12, LV: 2025-09-11, IE: 2025-09-12, RO: 2025-09-15, DE: 2025-09-10, PL: 2025-09-12, HU: 2025-09-12, CZ: 2025-09-09, ES: 2025-09-15, SK: 2025-09-11, LT: 2025-09-15

Condition(s): Moderate-to-Severe Chronic Obstructive Pulmonary Disease (COPD)
Product: Verekitug (UPB-101) Placebo, Verekitug (UPB-101)

Primary endpoint: Annualized rate of moderate or severe COPD exacerbation events compared with placebo over 108 weeks of treatment.
Endpoint(s): Change in pre-bronchodilator forced expiratory volume in 1 second (FEV1) compared with placebo from baseline to Week 60., Annualized rate of severe COPD exacerbation events compared with placebo over 108 weeks of treatment., Change in St. George’s Respiratory Questionnaire (SGRQ) total score compared with placebo from baseline to Week 60., Proportion of participants with SGRQ improvement of >4 points compared with placebo at Week 60., Incidence of treatment-emergent adverse events (TEAEs) and serious adverse events (SAEs) graded by Common Terminology Criteria for Adverse Events (CTCAE) version 5.0., Serum concentrations of verekitug and PK profile., Incidence of anti-drug antibodies (ADAs) during the study (including the post-treatment follow-up period).

Source: https://euclinicaltrials.eu/ctis-public/view/2025-520488-42-00